EU clinical trial 2024-514379-16-00: A First in human, Phase 1/2a, Multicentre, Open-label Study Evaluating the Safety, Tolerability, Pharmacokinetics, and Efficacy of PBP1510 in Patients with Advanced/Metastatic Pancreatic Cancer
Protocol code: PAUF-I
Sponsor: Prestige Biopharma Ltd (Pharmaceutical company). Phase: Phase I and Phase II (Integrated)- First administration to humans. Countries: Spain (ongoing, recruiting).
Therapeutic area(s): Diseases [C] - Neoplasms [C04]
Gender: Female, Male. Age: 18-64 years, 65+ years. Enrolment: 38.
Status: Ongoing, recruiting. Start date (EU): 2023-04-01. Decision date: 2024-10-02. Results received: No. Last updated: 2025-10-03.

Condition(s): Advanced and/or metastatic pancreatic adenocarcinoma
Product: Humanized immunoglobulin G1 (IgG1) kappa monoclonal antibody (mAb) targeting PAUF

Primary endpoint: Part 1 (Phase 1): Safety parameters including AEs, SAEs, DLTs, clinical laboratory values (haematology and blood chemistry), vital signs, and ECG assessments in patients, after receiving PBP1510 administered as monotherapy, and in combination with gemcitabine, following IV administration, in patients with pancreatic cancer whose tumours have progressed after at least one previous line of chemotherapy for locally advanced/metastatic disease., Part 2 (Phase 2a): Safety parameters including AEs, SAEs, clinical laboratory values (haematology and blood chemistry), vital signs, and ECG assessments in patients, after receiving PBP1510 administered at the RP2D in combination with gemcitabine, following IV administration, in patients with pancreatic cancer whose tumours have progressed after one previous line of chemotherapy for locally advanced/metastatic disease., Part 2 (Phase 2a): ORR (rate of patient with complete response [CR] or partial response [PR]) evaluated by Response Evaluation Criteria in Solid Tumours version v1.1 (RECIST v1.1), after receiving 4 cycles of PBP1510 administered at the RP2D in combination with gemcitabine, following IV administration, in patients with pancreatic cancer whose tumours have progressed after one previous line of chemotherapy for locally advanced/metastatic disease.
Endpoint(s): Part 1 (Phase 1): Cmax, Tmax, t1/2, AUC, MRT, Vss, Vc and CL of PBP1510 administered as monotherapy, and in combination with gemcitabine, following IV administration, in patients with pancreatic cancer whose tumours have progressed after at least one previous line of chemotherapy for locally advanced/metastatic disease., Part 1 (Phase 1): Cmax, Tmax, t1/2, AUC, MRT, and CL of gemcitabine administered in combination with PBP1510, following IV administration, in patients with pancreatic cancer whose tumours have progressed after at least one previous line of chemotherapy for locally advanced/metastatic disease., Part 1 (Phase 1): Presence of ADA and NAb against PBP1510 administered as monotherapy, and in combination with gemcitabine, following IV administration, in patients with pancreatic cancer whose tumours have progressed after at least one previous line of chemotherapy for locally advanced/metastatic disease., Part 1 (Phase 1) - Exploratory: Preliminary evidence of clinical outcomes as assessed by ORR after treatment with PBP1510 administered as monotherapy, and in combination with gemcitabine, following IV administration, in patients with pancreatic cancer whose tumours have progressed after at least one previous line of chemotherapy for locally advanced/metastatic disease., Part 1 (Phase 1) - Exploratory: Analysis of PAUF in tumour tissue pre-treatment and after treatment with PBP1510 administered as monotherapy, and in combination with gemcitabine, following IV administration, in patients with pancreatic cancer whose tumours have progressed after at least one previous line of chemotherapy for locally advanced/metastatic disease., Part 2 (Phase 2a): Ctrough, Cmax, Tmax, t1/2, AUC, MRT, Vss, Vc and CL of PBP1510 administered in combination with gemcitabine, following IV administration, in patients with pancreatic cancer whose tumours have progressed after one previous line of chemotherapy for locally advanced/metastatic disease., Part 2 (Phase 2a): Ctrough, Cmax, Tmax, t1/2, AUC, MRT, and CL of gemcitabine administered in combination with PBP1510, following IV administration, in patients with pancreatic cancer whose tumours have progressed after one previous line of chemotherapy for locally advanced/metastatic disease., Part 2 (Phase 2a): PFS, OS, and DoR after treatment with PBP1510 administered in combination with gemcitabine in patients with pancreatic cancer whose tumours have progressed after one previous line of chemotherapy for locally advanced/metastatic disease., Part 2 (Phase 2a): Presence of ADA and NAb against PBP1510 administered in combination with gemcitabine, following IV administration, in patients with pancreatic cancer whose tumours have progressed after one previous line of chemotherapy for locally advanced/metastatic disease., Part 2 (Phase 2a) - Exploratory: Pre-treatment PAUF expression and clinical efficacy outcome after treatment with PBP1510 administered in combination with gemcitabine, following IV administration, in patients with pancreatic cancer whose tumours have progressed after one previous line of chemotherapy for locally advanced/metastatic disease., Part 2 (Phase 2a) - Exploratory: Analysis of PAUF in tumour tissue pre-treatment and after treatment with PBP1510 administered in combination with gemcitabine, following IV administration, in patients with pancreatic cancer whose tumours have progressed after one previous line of chemotherapy for locally advanced/metastatic disease.

Source: https://euclinicaltrials.eu/ctis-public/view/2024-514379-16-00